EU clinical trial 2024-515506-11-00: A Phase 2, Open-Label, Randomized Study of Livmoniplimab in Combination with Budigalimab Versus Chemotherapy in Subjects with Metastatic Urothelial Carcinoma
Protocol code: M25-204
Sponsor: AbbVie Deutschland GmbH & Co. KG (Pharmaceutical company). Phase: Therapeutic exploratory (Phase II). Countries: Poland (ended), Spain (ongoing, recruitment ended), France (ended), Belgium (ended).
Therapeutic area(s): Diseases [C] - Neoplasms [C04]
Gender: Female, Male. Age: 18-64 years, 65+ years. Enrolment: 60.
Start date (EU): 2025-03-24. Decision date: 2025-03-03. Results received: No. Last updated: 2026-07-24.
Decision dates by country: BE: 2025-03-04, FR: 2025-03-06, PL: 2025-03-09, ES: 2025-03-03

Condition(s): Urothelial Carcinoma, Metastatic Urothelial Carcinoma
Product: Budigalimab, Paclitaxel 6 mg/mL concentrate for solution for infusion, Gemcitabine 38 mg/mL concentrate for solution for infusion, TAXOTERE 20 mg/1 ml concentrate for solution for infusion, Livmoniplimab

Primary endpoint: Overall survival (OS): The time measured from randomization until death from any cause.
Endpoint(s): Progression-Free survival (PFS): The time measured from randomization until the first documentation of progressive disease according to RECIST 1.1 as determined by investigators or death from any cause, whichever occurs first., Best Overall Response (BOR) of CR/PR: Defined as achieving complete response (CR) or partial response (PR) according to RECIST 1.1 as determined by investigators at any time prior to subsequent anticancer therapy., Duration of Response (DoR): The time from first CR/PR until the first documentation of progressive disease according to RECIST 1.1 as determined by investigators or death from any cause, whichever occurs first.

Source: https://euclinicaltrials.eu/ctis-public/view/2024-515506-11-00